EU clinical trial 2024-517363-24-00: Non‐Randomized, Open‐Label, Prospective Phase II Trial to Better Characterize the Status of HRD leading to a Benefit from Olaparib in Combination with Bevacizumab in Patients with Advanced FIGO Stage III‐IV High Grade Serous or Endometrioid Ovarian, Fallopian Tube, or Peritoneal Cancer After Standard First‐Line Treatment. STROBE
Protocol code: ESR-20-21103
Sponsor: Vall D Hebron Institute Of Oncology (Laboratory/Research/Testing facility). Phase: Therapeutic exploratory (Phase II). Countries: Spain (ongoing, recruiting).
Therapeutic area(s): Diseases [C] - Neoplasms [C04]
Gender: Female, Male. Age: 18-64 years, 65+ years. Enrolment: 100.
Status: Ongoing, recruiting. Start date (EU): 2024-02-16. Decision date: 2024-11-08. Results received: No. Last updated: 2026-07-20.
Decision dates by country: ES: 2025-01-08

Condition(s): Advanced FIGO Stage III‐IV High Grade Serous or Endometrioid Ovarian, Fallopian Tube, or Peritoneal Cancer
Product: BEVACIZUMAB, OLAPARIB

Primary endpoint: Percentage of HR status agreement between VHIO-CARD-300 test and SOPHiA DDM™ Dx HRD Solution. The corresponding 95% confidence intervals (CI) will be reported.
Endpoint(s): Sensitivity, specificity, predictive positive and negative value of the VHIO-CARD-300 test, using SOPHiA DDM™ Dx HRD Solution as a reference test., Progression free survival (PFS) and overall survival (OS) will be analysed in HRD and HRP groups, as determined by the VHIOCARD- 300 test. PFS: time from the date of enrolment to the date of first documentation of disease progression or death due to any cause, whichever occurs first. OS: time from the date of enrolment to the date of death due to any cause. The progression of disease will be assessed by the Investigator according to the modified Response Evaluation Criteria in Solid Tumours (RECIST 1.1) will be used., PFS and OS will be analysed in discrepant cases (i.e., HRD positive by VHIO-CARD- 300 test but HRD negative by SOPHiA DDM™ Dx HRD Solution and HRD negative by VHIO-CARD-300 test but HRD positive by SOPHiA DDM™ Dx HRD Solution)., Percentage of inconclusive results will be estimated for each test, Assessment of adverse events (AEs) graded by the National Cancer Institute (NCI) CTCAE v5.0, serious adverse events (SAEs), abnormal vital signs, abnormal ECG results, and evaluation of laboratory parameters.

Source: https://euclinicaltrials.eu/ctis-public/view/2024-517363-24-00